EU clinical trial 2024-520304-26-00: A phase 4, open-label study to evaluate the short-term innate immune response after administration of a COVID-19 mRNA vaccine (Comirnaty JN.1®) in healthy adults aged 18 to 40 years.
Protocol code: INNATE-GAP-CLIN
Sponsor: University Of Antwerp (Educational Institution). Phase: Therapeutic use (Phase IV). Countries: Belgium (ended).
Therapeutic area(s): Phenomena and Processes [G] - Immune system processes [G12]; Diseases [C] - Virus Diseases [C02]
Gender: Female, Male. Age: 18-64 years. Enrolment: 20.
Status: Ended. Start date (EU): 2025-05-05. End date (EU): 2025-05-27. Decision date: 2025-03-25. Results received: No. Last updated: 2025-05-27.

Condition(s): COVID-19
Product: Comirnaty JN.1 30 micrograms/dose dispersion for injection COVID-19 mRNA Vaccine

Primary endpoint: Before, 6 hours after, and 24 hours after the study intervention administration: - Levels of inflammatory biomarkers, such as but not limited to interferon gamma and interleukin-1 alpha and beta (geometric mean, median and quartiles), Before, 6 hours after, and 24 hours after the study intervention administration: - Immune profiling of PBMCs by cell surface protein expression analyses using barcoded antibodies against these marker proteins. - Transcriptomic analyses in PBMCs by single cell RNA sequencing.
Endpoint(s): Throughout the study duration: - Occurrence of any SAEs related to the vaccine administration as per the judgment of the investigator (percentage of participants).

Source: https://euclinicaltrials.eu/ctis-public/view/2024-520304-26-00